EU clinical trial 2024-516792-32-01: A Phase 2, Randomized, Blinded, Placebo-Controlled Trial Investigating the Efficacy and Safety of Visugromab versus Placebo, in Combination with Pembrolizumab, Pemetrexed, and Carboplatin, in First-Line Treatment of Participants with Metastatic Non-Squamous Non-Small Cell Lung Cancer (GDFATHER-NSCLC-01)
Protocol code: CTL-002-003
Sponsor: CatalYm GmbH (Pharmaceutical company). Phase: Therapeutic exploratory (Phase II). Countries: Bulgaria (ended), Spain (ongoing, recruiting), Romania (ongoing, recruiting), Poland (ongoing, recruiting), Germany (ongoing, recruiting), Italy (ongoing, recruiting).
Therapeutic area(s): Diseases [C] - Neoplasms [C04]
Gender: Female, Male. Age: 18-64 years, 65+ years. Enrolment: 82.
Start date (EU): 2025-07-18. Decision date: 2025-06-04. Results received: No. Last updated: 2026-07-08.
Decision dates by country: BG: 2025-06-12, PL: 2025-06-13, DE: 2025-06-04, IT: 2025-06-13, ES: 2025-06-09, RO: 2025-06-16

Condition(s): Metastatic non-squamous non-small cell lung cancer
Product: PEMETREXED, PEMBROLIZUMAB, Visugromab (CTL-002), CARBOPLATIN, Placebo for Visugromab

Primary endpoint: Objective response rate (ORR), defined as the percentage of participants with a best overall response (BOR) of complete response (CR) or partial response (PR) per Response Evaluation Criteria in Solid Tumors (RECIST) v1.1 as assessed by the Investigator at any time during the core trial period
Endpoint(s): 1. Incidence, type, and severity of adverse events (AEs), recorded as treatment-emergent (TEAEs), treatment-related AEs (including immune mediated AEs (imAEs) as AEs of Special Interest (AESIs)) and serious AEs (SAEs), 2. Complete response (CR) rate, 3. Partial response (PR) rate, 4. Objective response rate (ORR), 5. Time to response (TTR), 6. Duration of response (DOR), 7. Progression-free survival (PFS), 8. Overall survival (OS), 9. Participant weight course over time, 10. Maximum concentration (Cmax), 11. Minimum concentration (Cmin), 12. Participants’ subjective well-being as assessed via the Non-Small Cell Lung Cancer-Symptom Assessment Questionnaire (NSCLC-SAQ), 13. Participants' quality of life as assessed via the 5-day Functional Living Index-Emesis (5-day FLIE), focusing on the impact of chemotherapy-induced nausea and vomiting on daily activities and overall well-being

Source: https://euclinicaltrials.eu/ctis-public/view/2024-516792-32-01